EU clinical trial 2024-518636-36-00: Phase Ib/II trial of the combination of atezolizumab with dendritic cell vaccination as maintenance treatment in patients with extensive stage small cell lung cancer (ES-SCLC) after induction treatment.
Protocol code: IOR-IISML42037
Sponsor: Instituto Oncologico Dr. Rosell S.L. (Hospital/Clinic/Other health care facility). Phase: Phase I and Phase II (Integrated)- Bioequivalence Study. Countries: Spain (ended).
Therapeutic area(s): Diseases [C] - Neoplasms [C04]
Gender: Female, Male. Age: 18-64 years, 65+ years. Enrolment: 20.
Status: Ended. Start date (EU): 2024-10-10. End date (EU): 2025-09-08. Decision date: 2024-10-10. Results received: Yes. Last updated: 2025-08-12.

Condition(s): Lung Cancer
Product: AUTOLOGOUS DENDRITIC CELLS LOADED WITH AUTOLOGOUS TUMOR LYSATE, Tecentriq 1 200 mg concentrate for solution for infusion

Primary endpoint: Progression-Free Survival (PFS) rate at 6 months: Calculated as the percentage of participants alive and without disease progression, as assessed by the Investigator using RECIST v1.1, at 6 months.
Endpoint(s): Duration of clinical benefit (DCB) as per RECIST 1.1: DCB calculated as the time (in months) from first dose of treatment to progression (or death from any cause) in patients who had a best overall response of CR, PR, or SD of ≥ 24 weeks., Overall Survival (OS): Overall Survival (OS) is calculated as the time from date of inclusion to date of death due to any cause., Response rate (ORR): rate of patients that achieve partial or complete response as best response during study induction treatment (ORR1) and rate of patients that have a further best response during maintenance treatment (ORR2).

Source: https://euclinicaltrials.eu/ctis-public/view/2024-518636-36-00